EU clinical trial 2024-513209-30-00: Randomised, double-blind, multicentre, phase III clinical trial to evaluate the efficacy and safety of dexamethasone compared to placebo in patients with severe influenza (FLUDEX)
Protocol code: FLUDEX
Sponsor: Fundacion De La Comunitat Valenciana Para La Gestion Del Instituto De Investigacion Sanitaria Y Biomedica De Alicante (Laboratory/Research/Testing facility). Phase: Therapeutic confirmatory (Phase III). Countries: Spain (ongoing, recruiting).
Therapeutic area(s): Diseases [C] - Respiratory Tract Diseases [C08]; Diseases [C] - Virus Diseases [C02]
Gender: Female, Male. Age: 18-64 years, 65+ years. Enrolment: 486.
Status: Ongoing, recruiting. Start date (EU): 2024-11-20. Decision date: 2024-10-22. Results received: No. Last updated: 2025-10-27.

Condition(s): Severe Influenza
Product: CELLULOSE, MICROCRYSTALLINE, OSELTAMIVIR, DEXAMETHASONE

Primary endpoint: Percentage of patients in status greater than or equal to 3 (3,4,5 or 6) according to the Hospital Recovery Scale (HRS) on day 7 after the start of treatment.
Endpoint(s): Time elapsed in days between the start of treatment and clinical stability, defined by NEWS-2<2 scale for >24 hours or hospital discharge (first event)., Hospital stay: expressed in days, taken from the discharge date and date of admission., Admission to the ICU: from any cause, and related or not to influenza (or its secondary complications) in the opinion of the researcher. Discharge date and date of admission., Need or not for non-invasive mechanical ventilation (NIMV), with the start/end date., Need or not for invasive mechanical ventilation (IMV) with the admission/discharge date., Death: death from any cause, whether or not related to influenza (or its complications) in the opinion of the investigator., Clinical failure: defined as clinical progression requiring admission to the ICU, invasive mechanical ventilation or death (from any cause) within 72 hours after the start of treatment in the control or experimental arm. Date., Dependency index: measured with the Barthel index with a score from 0 to 100. Questionnaire that evaluates individual capabilities in 10 basic activities of daily living (Annex IV.-C). It will be measured at the baseline visit (with reference to the 15 days prior to admission), at the end of treatment or at hospital discharge (whichever comes first) and at follow-up visits 30 and 90., Frailty index: measured by the Rockhood scale or Clinical Frailty Score that classifies on a scale of 1 to 8 according to the level of dependency and which serves as a global clinical measure of physical fitness and frailty (Annex IV.-D). It will be measured at the baseline visit (with reference to the 15 days prior to admission), at the end of treatment or at hospital discharge (whichever comes first) and at follow-up visits 30 and 90., Evaluation of the impact of steroid treatment on the nasal microbiome: evaluation of alpha diversity variation (using Index of Shannon, number of ASV's) and determination of the differential taxa based on the outcome variables on day 10 post-randomization with respect to the baseline determination (Annex VI)., Shannon index, defined as the quantification index of diversity and richness of microbial species, evaluates quantity and equity of its distribution., Amplicon Sequence Variants (ASV's), defined as specific DNA sequence obtained from techniques of massive sequencing and that identifies different taxa., Evaluation of viral kinetics: quantification of viral load by Ct (cycle number 10-40) and total RNA/mcg DNA copies at basal level, day 2, 5 and 10 (Annex VI)., Evaluation of the impact of inflammation markers: measurement of leukocytes, lymphocytes, CRP, PCT (optional), total number of leukocytes and lymphocytes, IL-1 and IL6 will be carried out at baseline, day 2, 5, 7 and 10 (Annex VI).

Source: https://euclinicaltrials.eu/ctis-public/view/2024-513209-30-00